EU clinical trial 2025-525059-23-00: The effect of losartan on cephalexin
Protocol code: T2025/25858 KEFALOS
Sponsor: Varsinais-Suomen hyvinvointialue (Hospital/Clinic/Other health care facility). Phase: Human Pharmacology (Phase I)- Other. Countries: Finland (ongoing, recruitment ended).
Therapeutic area(s): Not possible to specify
Gender: Female, Male. Age: 18-64 years. Enrolment: 12.
Status: Ongoing, recruitment ended. Start date (EU): 2026-03-04. Decision date: 2026-02-26. Results received: No. Last updated: 2026-04-14.

Condition(s): healthy volunteers

Source: https://euclinicaltrials.eu/ctis-public/view/2025-525059-23-00